EU clinical trial 2024-510959-35-00: Multicenter, randomized, double-blind, and placebo-controlled clinical trial to assess the efficacy and safety of donepezil versus placebo in mild cognitive impairment associated with Parkinson's disease.
Protocol code: IIBPS-DON-2022-43
Sponsor: Fundacio Institut De Recerca De L Hospital De La Santa Creu I Sant Pau (Hospital/Clinic/Other health care facility). Phase: Therapeutic exploratory (Phase II). Countries: Spain (ongoing, recruiting).
Therapeutic area(s): Diseases [C] - Nervous System Diseases [C10]
Gender: Female, Male. Age: 18-64 years, 65+ years. Enrolment: 120.
Status: Ongoing, recruiting. Start date (EU): 2023-09-07. Decision date: 2024-06-12. Results received: No. Last updated: 2025-04-14.

Condition(s): Parkinson's disease
Product: ARICEPT 10mg comprimidos recubiertos con película

Primary endpoint: Parkinson's Disease-Cognitive Rating Scale (PD-CRS), Parkinson's Disease-Cognitive Functional Rating Scale (PD-CFRS)
Endpoint(s): Trail Making Test A (TMT-A), Digit Span directo (DSd), Trail Making Test B (TMT-B), Phonemic fluency, Boston Nomination Test reduced (BNTr), Semantic fluency, Free and Cued Selective Reminding Test (FCSRT), Figura compleja de Rey-Osterrieth (ROCF) y recuerdo de ROCF (rROCF), Judgement of Line Orientation (JLO), Hospital Anxiety and Depression Scale (HADS), Starkstein Apathy Scale (AS), Neuropsychiatric Inventory (NPI), MDS UPDRS-I y -II, Schwab & England scale (S&E):, 8-item Parkinson’s Disease Questionnaire (PDQ-8), Clinical Global Impressions (CGI-S y CGI-I), Patients Global Impression of Change (PGIC)

Source: https://euclinicaltrials.eu/ctis-public/view/2024-510959-35-00